EU clinical trial 2023-506623-29-01: A randomized trial comparing efficacy and safety of etanercept and methotrexate in giant cell arteritis (EFFECTA)
Protocol code: ABM/EFFECTA/2023
Sponsor: Wojskowy Instytut Medyczny Panstwowy Instytut Badawczy (Hospital/Clinic/Other health care facility). Phase: Therapeutic exploratory (Phase II). Countries: Poland (ongoing, recruiting).
Therapeutic area(s): Diseases [C] - Immune System Diseases [C20]; Diseases [C] - Musculoskeletal Diseases [C05]
Gender: Female, Male. Age: 18-64 years, 65+ years. Enrolment: 88.
Status: Ongoing, recruiting. Start date (EU): 2025-03-12. Decision date: 2024-05-21. Results received: No. Last updated: 2026-02-24.

Condition(s): Giant cell arteritis
Product: METHOTREXATE, METHOTREXATE, FOLIC ACID, FOLIC ACID, METHOTREXATE, METHOTREXATE, METHOTREXATE, PREDNISONE, METHOTREXATE, PREDNISONE, METHOTREXATE, PREDNISONE, METHOTREXATE, METHYLPREDNISOLONE, ETANERCEPT, METHYLPREDNISOLONE, PREDNISONE

Primary endpoint: Percentage of sustained steroid-free GCA remission at week 52 from randomization, defined as lack of symptoms and signs attributable to GCA and not related to prior damage and normalization of inflammatory markers (i.e. ESR < 30 mm/1 hour and CRP < 10 mg/L) with adherence to the protocol-defined prednisone taper regimen.
Endpoint(s): Mortality rate in the course of GCA at 52 and 104 week from randomization., Percentage of severe ischemic complications of GCA at 52 and 104 week, defined as: a. stroke, b. myocardial infarction, c. complete or partial vision loss, d. limb ischemia, e. ischemia of organs important for the patient's survival (i.e. lungs, kidneys, alimentary tract)., Percentage of sustained steroid-free GCA remission at week 104 from randomization, defined as lack of symptoms and signs attributable to GCA and not related to prior damage and normalization of inflammatory markers (ESR < 30 mm/1 hour and CRP < 10 mg/L) with adherence to the protocol-defined prednisone taper regimen., Percentage of GCA remission at 24, 52, 78 and 104 week from randomization, defined as lack of symptoms and signs attributable to GCA and not related to prior damage and normalization of inflammatory markers (i.e. ESR < 30 mm/1 hour and CRP < 10 mg/L)., Percentage of GCA remission (defined as lack of symptoms and signs attributable to GCA and not related to prior damage and normalization of inflammatory markers, i.e. ESR < 30 mm/1 hour and CRP < 10 mg/L) with concomitant achievement of prednisone dose ≤ 5mg/day at 26, 52, 78 and 104 week from randomization., Percentage of GCA remission (defined as lack of symptoms and signs attributable to GCA and not related to prior damage and normalization of inflammatory markers, i.e. ESR < 30 mm/1 hour and CRP < 10 mg/L) with concomitant achievement of prednisone dose ≤ 7,5mg/day at 26, 52, 78 and 104 week from randomization., Cumulative dose of prednisone at 26, 52, 78 and 104 week from randomization., Time to GCA relapse (after achieving remission)., Major GCA relapse within 26, 52, 78 and 104 weeks from randomization., Minor GCA relapse within 26, 52, 78 and 104 weeks from randomization., Change in quality of life measured by SF-36 v.2 questionnaire at 26, 52, 78 and 104 week (compared to the randomization visit)., Occurrence of serious adverse events within 26, 52, 78 and 104 weeks from randomization., Occurrence of non-serious adverse events within 26, 52, 78 and 104 weeks from randomization.

Source: https://euclinicaltrials.eu/ctis-public/view/2023-506623-29-01